EU clinical trial 2024-519261-21-00: Phase II study of lurbinectedin and irinotecan in adult and young adult patients with advanced desmoplastic small round cell tumor (DSRCT)
Protocol code: ISG-TULIPS
Sponsor: Italian Sarcoma Group (Patient organisation/association). Phase: Therapeutic exploratory (Phase II). Countries: Spain (authorised, recruitment pending), Italy (ongoing, recruiting).
Therapeutic area(s): Diseases [C] - Neoplasms [C04]
Gender: Female, Male. Age: 0-17 years, 18-64 years, 65+ years. Enrolment: 20.
Start date (EU): 2025-11-21. Decision date: 2025-09-30. Results received: No. Last updated: 2025-10-02.
Decision dates by country: IT: 2025-09-30, ES: 2025-10-02

Condition(s): Desmoplastic small round cell tumor
Product: Irinotecán Accord 20 mg/ml concentrado para solución para perfusión EFG, Irinotecán Accord 20 mg/ml concentrado para solución para perfusión EFG, lurbinectedin, Irinotecán Accord 20 mg/ml concentrado para solución para perfusión EFG, Irinotecán Accord 20 mg/ml concentrado para solución para perfusión EFG, Irinotecán Accord 20 mg/ml concentrado para solución para perfusión EFG

Primary endpoint: Overall tumour Response Rate (ORR), according to RECIST v 1.1
Endpoint(s): Overall Survival (OS), Progression Free Survival (PFS), Duration of Response (DoR), Safety (according to CTC-AE v.5), EORTC-QLQ-C30 and brief inventory pain

Source: https://euclinicaltrials.eu/ctis-public/view/2024-519261-21-00